EU clinical trial 2024-511442-39-00: Combination of baricitinib and anti-TNF vs. baricitinib alone in patients with rheumatoid arthritis: a randomized placebo-controlled phase-III trial - CRI-RA
Protocol code: CHUBX 2019/56
Sponsor: Centre Hospitalier Universitaire De Bordeaux (Hospital/Clinic/Other health care facility). Phase: Therapeutic confirmatory (Phase III). Countries: France (ongoing, recruiting).
Therapeutic area(s): Phenomena and Processes [G] - Immune system processes [G12]
Gender: Female, Male. Age: 18-64 years. Enrolment: 169.
Status: Ongoing, recruiting. Start date (EU): 2025-02-05. Decision date: 2024-05-02. Results received: No. Last updated: 2025-12-10.

Condition(s): Rheumatoid arthritis (RA)
Product: Imraldi 40 mg solution for injection in pre-filled pen, Benepali 50 mg solution for injection in pre-filled pen., PL1 : placebo - Imraldi (strictly identical) AND Benepali (not strictly identical), PREDNISONE, Olumiant 4 mg film-coated tablets

Primary endpoint: Proportion of patients who achieve an ACR 50 response at week 24 in each treatment group (COMBI group (adalimumab + baricitinib) vs. MONO group (baricitinib conventional therapy)
Endpoint(s): Main secondary endpoints : Proportion of AEs and SAEs in each treatment group, Proportion of patients who achieve an ACR20 response and an ACR70 response at weeks 4, 12 and 24 in each treatment group, Proportion of patients who achieve an ACR50 response at weeks 4 and 12 in each treatment group, Proportion of patients who present a EULAR response at weeks 4, 12 and 24, according to DAS28-ESR, in each treatment group, Proportion of patients who achieve remission or low disease activity at weeks 4, 12 and 24, according to DAS28-ESR, in each treatment group, Quantitative change in DAS28-ESR, DAS28-CRP, sDAI and cDAI scores between baseline and each visit (until week 24 included) for each treatment group of treatment, Drug retention rates at weeks 4, 12 and 24 in each treatment group, Proportion of patients who decrease the glucocorticosteroid dose ≤ 5 mg per day, sustained from week 12 to week 24, among patients with a baseline dose > 5 mg per day, in each treatment group, Quantitative change in patient-reported outcomes (HAQ, FACIT, RAID) between baseline, weeks 4, 12 and 24 visit in each treatment group, Proportion of participants maintaining an ACR50 response, remission or low disease activity at week 52 in each treatment group., Quantitative change in DAS28-ESR, DAS28-CRP, sDAI and cDAI scores between weeks 24 and 52 in each treatment group., Main secondary endpoints : Quantitative change in DAS28-CRP, between baseline and week 24 for each treatment group of treatment

Source: https://euclinicaltrials.eu/ctis-public/view/2024-511442-39-00